EU clinical trial 2024-518001-18-00: Endocrine, Cardiovascular, Pharmacological, and Physiological Aspects of Sex Hormone Therapy in Turner Syndrome - Study 2
Sponsor: Region Midtjylland (Hospital/Clinic/Other health care facility). Phase: Therapeutic use (Phase IV). Countries: Denmark (ongoing, recruiting).
Therapeutic area(s): Diseases [C] - Hormonal diseases [C19]
Gender: Female. Age: 18-64 years. Enrolment: 100.
Status: Ongoing, recruiting. Start date (EU): 2021-11-29. Decision date: 2024-10-08. Results received: No. Last updated: 2024-10-08.

Condition(s): Turner syndrome
Product: Estrofem, filmovertrukne tabletter, Divigel 1 mg gel

Primary endpoint: Body composition: measured by bio impedance, Blood test values: changes in the blood test values from baseline within the areas of metabolism, endocrinology, cardiovascular function, and coagulation, Cardiovascular status: 24-hour ambulatory blood pressure monitoring and arterial stiffness (measured by SphygmoCor), Muscle quality: MR scan of both quadriceps measuring muscle cross-sectional area (CSA) and fat content of the muscle. Maximal isometric muscle strength of both quadriceps (functional muscle tests). Muscle quality = maximum quadriceps strength measured in nM/muscle CSA., Quadriceps strength test: maximal isometric muscle strength of both quadriceps measured simultaneously, Isometric hand strength test: maximal hand strength measured in kilograms, Fitness: maximal oxygen uptake measured by a VO2max test, Bones: bone mineral density as measured by a DEXA scan, Jumping heigth: maximal jumping heigth measured in centimeters
Endpoint(s): Self-reported health-related quality of life and functioning (SF-36), Self-reported quality of life (WHOQoL-Bref), Subjective assesment of the medication after 6 months of oral and six months of transdermal treatment

Source: https://euclinicaltrials.eu/ctis-public/view/2024-518001-18-00